EU clinical trial 2023-505521-14-00: A Single-Dose Two-Period Crossover Study to Assess the Effect of Food on MK-5684 Pharmacokinetics and to Monitor Pharmacodynamic Effects Over Time in Healthy Participants
Protocol code: MK-5684-007
Sponsor: Merck Sharp & Dohme LLC (Pharmaceutical company). Phase: Human Pharmacology (Phase I)- Other. Countries: Belgium (ended).
Therapeutic area(s): Diseases [C] - Neoplasms [C04]
Gender: Male. Age: 18-64 years. Enrolment: 14.
Status: Ended. Start date (EU): 2023-08-02. End date (EU): 2023-11-09. End date: 2024-01-31. Decision date: 2023-07-25. Results received: Yes. Last updated: 2023-07-25.

Condition(s): refractory metastatic prostate cancer
Product: Astonin H 0,1 mg comprimate, Prednison acis 5 mg

Primary endpoint: Area Under the Concentration-Time Curve From Time Zero to Last Measured Concentration (AUC 0-last), Area Under the Concentration-Time Curve From Time 0 to Infinity (AUC 0-inf) of MK-5684, Maximum Concentration (Cmax) of MK-5684, Percent Change From Baseline in Testosterone Level, Percent Change From Baseline in Androstenedione Level, Percent Change From Baseline in Pregnenolone Level, Percent Change From Baseline in Dehydroepiandrosterone Sulfate (DHEA-S) Level
Endpoint(s): Number of Participants Who Experience an Adverse Event (AE), Number of Participants Who Discontinue Study Treatment Due to an AE, Time to Maximum Concentration of MK-5684, Half-Life (t1/2) of MK-5684, Oral Clearance (CL/F) of MK-5684, Apparent Volume of Distribution (Vz/F) of MK-5684, Terminal Elimination Rate Constant (λz) of MK-5684

Source: https://euclinicaltrials.eu/ctis-public/view/2023-505521-14-00